EU clinical trial 2025-523921-17-00: Interleukin-1 inhibition to improve the response of myeloproliferative neoplasms resistant to cytoreductive treatment
Protocol code: 29BRC25.0416
Sponsor: Centre Hospitalier Regional Et Universitaire De Brest (Hospital/Clinic/Other health care facility). Phase: Therapeutic exploratory (Phase II). Countries: France (authorised, recruitment pending).
Therapeutic area(s): Diseases [C] - Hemic and Lymphatic Diseases [C15]
Gender: Female, Male. Age: 18-64 years, 65+ years. Enrolment: 50.
Status: Authorised, recruitment pending. Decision date: 2026-07-02. Results received: No. Last updated: 2026-07-02.

Condition(s): myeloproliferative neoplasms
Product: Kineret 100 mg/0.67 ml solution for injection in pre-filled syringe.

Primary endpoint: Baseline and 3-month serum calprotectin levels.
Endpoint(s): - Improvement (yes/no) of the response statusresponse status (according to ELN criteria) between baseline-M3, baseline-M6, M3-M6, - hematological parameters (e.g., hemoglobin, hematocrit, white blood cell count, platelet count) at baseline, 3 and 6 months.., - Patient-reported symptom severity over the previous 4 weeks assessed using a 10-point Visual Analog Scale (VAS) for pruritus, fever, and night sweats at baseline, 3 and 6 months., - Treatment-related adverse events (type and number), - Daily self-reported treatment intake (Yes/No) recorded in the patient diary over the 3-month period, - EORTC QLQ-C30 score at baseline, 3 and 6 months, - Multiplex assay of inflammatory cytokines at baseline, 3 and 6 months, - Quantification of JAK2V617F, CALR exon 9, or MPL W515 at baseline, 3 and 6 months, - Measurement of circulating CD34+ cells at baseline, 3 and 6 months

Source: https://euclinicaltrials.eu/ctis-public/view/2025-523921-17-00